EU clinical trial 2024-512322-28-00: Multicenter Phase 3 Pivotal Study to Evaluate the Safety and Efficacy of TOOKAD (padeliporfin) Vascular Targeted Photodynamic Therapy in the Treatment of Low-Grade Upper Tract Urothelial Cancer
Protocol code: CLIN2001UCM301
Sponsor: Steba Biotech S.A. (Pharmaceutical company). Phase: Therapeutic confirmatory (Phase III). Countries: Germany (ongoing, recruitment ended), Austria (ended), Spain (ongoing, recruitment ended), Italy (ended), France (ongoing, recruitment ended).
Therapeutic area(s): Diseases [C] - Neoplasms [C04]
Gender: Female, Male. Age: 18-64 years, 65+ years. Enrolment: 50.
Start date (EU): 2022-10-25. Decision date: 2024-05-14. Results received: No. Last updated: 2026-08-04.
Decision dates by country: IT: 2024-05-20, AT: 2024-05-21, FR: 2024-05-24, ES: 2024-05-17, DE: 2024-05-14

Condition(s): Low Grade Upper Tract Urothelial Cancer
Product: PADELIPORFIN, TOOKAD 183 mg powder for solution for injection

Primary endpoint: The primary efficacy outcome is the absence of UTUC tumors in the entire ipsilateral calyces, renal pelvis and ureter on endoscopic evaluation. This outcome will be determined dichotomously as either failure or success in achieving complete response., Complete Response will be defined as absence of disease based on: •absence of visual tumor on endoscopy •no evidence of tumor on biopsy (if feasible) •negative urinary cytology by instrumented collection, Additional information are part of the protocol (section Primary Endpoint/Estimand)
Endpoint(s): The duration of response at the entire ipsilateral kidney will be defined as absence of disease in the entire ipsilateral calyces, renal pelvis and ureter, The duration of response at the Treatment Area of the ipsilateral kidney will be defined as absence of disease in the ipsilateral Treatment Area, Overall renal functional outcome, Kidney organ loss or preservation, Pathological evaluation of response performed in kidney tissue of patient that will undergo kidney surgical removal following at least one TOOKAD (padeliporfin) VTP treatment, Safety follow up based and recording of adverse events, Additional information are part of the protocol (section Secondary Endpoint/Estimand)

Source: https://euclinicaltrials.eu/ctis-public/view/2024-512322-28-00